EU clinical trial 2024-519812-15-00: ETCABio - Evaluation of Skin Tests in Biotherapy Allergies
Sponsor: Centre Hospitalier Universitaire D'Angers (Hospital/Clinic/Other health care facility). Phase: Therapeutic use (Phase IV). Countries: France (ongoing, recruiting).
Therapeutic area(s): Diseases [C] - Neoplasms [C04]
Gender: Female, Male. Age: 18-64 years, 65+ years. Enrolment: 140.
Status: Ongoing, recruiting. Start date (EU): 2026-06-17. Decision date: 2025-04-10. Results received: No. Last updated: 2026-03-19.

Condition(s): deficient mismatch repair (dMMR) colorectal cancer, Follicular lymphoma, Chronic lymphocytic leukemia (CLL), Pleural mesothelioma, Melanoma, Small cell lung carcinoma, AL amyloidosis, Hepatocellular carcinoma, Hodgkin lymphoma, Cholangiocarcinoma, Locally advanced cutaneous squamous cell carcinoma, Non-small cell lung carcinoma, deficient mismatch repair (dMMR) colorectal adenocarcinoma, Esophageal squamous cell carcinoma, Gastric cardia cancer, Myeloma
Product: NIVOLUMAB, PEMBROLIZUMAB, ATEZOLIZUMAB, DURVALUMAB, OBINUTUZUMAB, CEMIPLIMAB, DARATUMUMAB

Primary endpoint: For each biotherapy studied, the maximum usable concentration considered non-irritant is defined as the maximum concentration that does not produce a skin reaction in at least 9 out of 10 patients (90% specificity) during skin testing.
Endpoint(s): A delayed reaction is considered if, at the intradermal injection sites, a skin reaction occurs 48 hours or one week after injection, or if a systemic reaction occurs following biotherapy administration. Patients will be contacted by phone to confirm the presence or absence of a delayed local reaction, and if necessary, a photograph taken during a consultation with the allergologist investigator or in a video consultation will confirm the reaction.

Source: https://euclinicaltrials.eu/ctis-public/view/2024-519812-15-00